EU clinical trial 2025-524449-28-00: A Dose-Escalation Study Evaluating the Safety and Pharmacokinetics of IMC-S118AI in HLA-A*02:01-Positive Participants With Type 1 Diabetes
Protocol code: IMC-S118AI-1007
Sponsor: Immunocore Limited (Pharmaceutical company). Phase: Human Pharmacology (Phase I)- First administration to humans. Countries: Austria (authorised, recruitment pending).
Therapeutic area(s): Diseases [C] - Nutritional and Metabolic Diseases [C18]
Gender: Female, Male. Age: 0-17 years, 18-64 years. Enrolment: 20.
Status: Authorised, recruitment pending. Decision date: 2026-07-17. Results received: No. Last updated: 2026-07-17.

Condition(s): Type 1 Diabetes
Product: 0.9% Sodium Chloride Intravenous Infusion Solution, IMC-S118AI

Primary endpoint: Incidence and severity of AEs, TEAEs, and SAEs, Changes in safety laboratory parameters, vital signs, and electrocardiogram, Incidence of dose interruptions, reductions, and discontinuations
Endpoint(s): IMC-S118AI PK parameters after single and multiple doses, Incidence of anti-IMC-S118AI antibody formation, Change from Baseline in AUC of serum C-peptide at Week 25 in participants treated with IMC-S118AI compared to placebo

Source: https://euclinicaltrials.eu/ctis-public/view/2025-524449-28-00